EU clinical trial 2024-512961-15-00: A Phase 3, Multicenter, Randomized, Double-blind, Placebo-Controlled Study of AG-881 in Subjects With Residual or Recurrent Grade 2 Glioma With an IDH1 or IDH2 Mutation
Protocol code: AG881-C-004
Sponsor: Institut De Recherches Internationales Servier IRIS (Pharmaceutical company). Phase: Therapeutic confirmatory (Phase III). Countries: Germany (ongoing, recruitment ended), France (ongoing, recruitment ended), Italy (ongoing, recruitment ended), Spain (ongoing, recruitment ended), Netherlands (ongoing, recruitment ended).
Therapeutic area(s): Diseases [C] - Neoplasms [C04]
Gender: Female, Male. Age: 0-17 years, 18-64 years, 65+ years. Enrolment: 71.
Status: Ongoing, recruitment ended. Start date (EU): 2020-08-05. Decision date: 2024-07-15. Results received: No. Last updated: 2026-04-10.
Decision dates by country: FR: 2024-07-22, IT: 2024-07-22, ES: 2024-07-17, NL: 2024-07-15, DE: 2024-07-22

Condition(s): Residual or Recurrent Grade 2 Glioma With an IDH1 or IDH2 Mutation
Product: Placebo tablets to match S95032 drug product are supplied as white to off-white, round (10 mg) and white to off-white oblong (40 mg) film-coated tablets for oral administration., S95032/AG-881, S95032/AG-881

Primary endpoint: Radiographic PFS as assessed by the BIRC per modified Response Assessment for Neuro-oncology for Low-Grade Gliomas [RANO-LGG]
Endpoint(s): 1. The key secondary endpoint is TTNI., 2.Other secondary efficacy endpoints are TGR, objective response, CR+PR, time to response, time to CR+PR, duration of response, duration of CR+PR, OS, FACT-BR scores, and PFS by investigator., 3. Adverse events, serious adverse events (SAEs), and AEs leading to discontinuation or death, and severity of AEs, 4. Safety laboratory parameters, vital signs, 12-lead electrocardiograms (ECGs), evaluation of left ventricular ejection fraction (LVEF), Karnofsky Performance Scale (KPS)/Lansky Play-Performance Scale (LPPS), and concomitant medications., 5. Serial or sparse blood sampling at specified time points for determination of plasma concentration-time profiles and PK parameters of vorasidenib and its circulating metabolite AGI-69460.

Source: https://euclinicaltrials.eu/ctis-public/view/2024-512961-15-00